EU clinical trial 2022-500024-30-00: A non-inferiority, randomised and controlled trial to compare the safety, tolerability and preliminary efficacy between standard and Torque Teno virus-guided immunosuppression in stable adult kidney transplant recipients with low immunological risk in the first year after transplantation
Protocol code: TTV GUIDE IT
Sponsor: Medical University Of Vienna (Hospital/Clinic/Other health care facility). Phase: Therapeutic exploratory (Phase II). Countries: Netherlands (ended), Czechia (ended), France (ended), Austria (ended), Germany (ended), Spain (ended).
Therapeutic area(s): Diseases [C] - Nutritional and Metabolic Diseases [C18]
Gender: Female, Male. Age: 18-64 years, 65+ years. Enrolment: 260.
Status: Ended. Start date (EU): 2022-08-23. End date (EU): 2025-05-26. Decision date: 2022-06-28. Results received: Yes. Last updated: 2023-06-19.
Decision dates by country: DE: 2022-07-01, FR: 2022-06-28, CZ: 2022-07-01, NL: 2022-06-30, AT: 2022-07-01, ES: 2022-07-08

Condition(s): Post Kidney transplantation
Product: TACROLIMUS, TACROLIMUS, TACROLIMUS

Primary endpoint: A composite of one of the following: 1. Infectious disease event requiring one of the following: a) Inpatient treatment (including day-care) b) Application of anti-bacteria, fungal, viral and protozoal drugs c) Reduction of immunosuppression; SARS-CoV-2 infection (including positive antigen or PCR test) with or without COVID-19 is excluded; 2. Allograft rejection detected upon indication biopsy; 3. Death; 4. Graft loss
Endpoint(s): Single components of the composite primary end point, Composite of all components of the primary end point, whereas episodes of infection and graft rejection are scored by the treat- ing medical personnel, Composite of all components of the primary end point, whereas infections are restricted to severe of infections (necessitating treatment in the inpatient or day-care ward) and rejections are restricted to severe rejections (excluding BL TCMR), Estimated glomerular filtration rate (eGFR; current CKD EPI and MDRD abbreviated), Rejection detected by protocol biopsy at month 12 post- transplantation: according to BANFF 2019 meeting report (including/excluding BL TCMR) and according to molecular microscope (MMDX), de novo donor specific antibodies (DSA), Plasma TTV load, TAC trough level and dose, Unchanged, increased, and decreased TAC trough target levels, Health related quality of live: SF-36 and MTSOSD-59R questionnaires, Drug adherence assessed according to paper-based assessment, MEMS® Buttons (AARDEX Group, Switzerland) on TAC blisters, BAASIS questionnaire, claimed prescriptions, psychological evaluation and TAC trough level variability, Adverse Events and Serious Adverse Events (AEs/SAEs), Development of malignoma, The three in CTIS ID no. 1,2 and 3 mentioned secondary end-points including COVID-19, Episodes of infection due to SARS-CoV-2

Source: https://euclinicaltrials.eu/ctis-public/view/2022-500024-30-00